EU clinical trial 2023-509220-17-00: A Phase I/IIa, Open-label, Multi-center Study to Assess the Safety, Tolerability, Pharmacokinetics, and Preliminary Efficacy of the DNA Polymerase Theta Inhibitor ART6043 Administered Orally as Monotherapy and in Combination to Patients with Advanced or Metastatic Solid Tumors
Protocol code: ART6043C001
Sponsor: Artios Pharma Limited (Pharmaceutical company). Phase: Phase I and Phase II (Integrated)- First administration to humans. Countries: Spain (ongoing, recruiting).
Therapeutic area(s): Diseases [C] - Neoplasms [C04]
Gender: Female, Male. Age: 18-64 years, 65+ years. Enrolment: 55.
Status: Ongoing, recruiting. Start date (EU): 2026-04-10. Decision date: 2024-07-19. Results received: No. Last updated: 2026-04-23.

Condition(s): Metastatic solid tumors, Advanced solid tumors
Product: Lynparza 150 mg film-coated tablets, Lynparza 100 mg film-coated tablets, ART6043, ART6043, ART6043, ART6043, ART6043

Primary endpoint: Part A: Incidence of Dose Limiting Toxicities (DLTs); incidence and severity of Adverse Events (CTCAE v5.0), Part B2: Progression free survival (PFS) (based on RECIST v1.1)
Endpoint(s): Part B2: Incidence and severity of Adverse events (CTCAE v5.0), Best overall response (BOR), Objective Response Rate (ORR), Disease control rate (DCR), Duration of response (DOR) and change in tumor size, Serological tumor markers, Part A: Progression free survival (PFS), Overall survival (OS), ART6043 and ART7276 plasma concentration data, Olaparib plasma concentration data, Archival tumor or pre-dose tumor biopsy

Source: https://euclinicaltrials.eu/ctis-public/view/2023-509220-17-00